EU clinical trial 2023-509900-14-00: A Study to Assess Distribution, Binding, and Retention of the Monoclonal Antibody Trontinemab in the Brain of Healthy Participants and Patients with Alzheimer’s Disease
Protocol code: BP45211
Sponsor: F. Hoffmann-La Roche AG (Pharmaceutical company). Phase: Human Pharmacology (Phase I)- Other. Countries: Netherlands (ongoing, recruitment ended).
Therapeutic area(s): Diseases [C] - Nervous System Diseases [C10]
Gender: Female, Male. Age: 18-64 years, 65+ years. Enrolment: 20.
Status: Ongoing, recruitment ended. Start date (EU): 2024-12-10. Decision date: 2024-10-15. Results received: No. Last updated: 2026-06-18.

Condition(s): Alzheimer’s Disease (AD)

Source: https://euclinicaltrials.eu/ctis-public/view/2023-509900-14-00